EU clinical trial 2025-524175-23-00: Impact of Early Thyroid Hormone Replacement on Kidney Function and Health-Related Quality of Life in Patients at Risk of Postoperative Hypothyroidism after Hemithyroidectomy: A Randomised Controlled Trial
Sponsor: Region Midtjylland (Hospital/Clinic/Other health care facility). Phase: Therapeutic use (Phase IV). Countries: Denmark (ongoing, recruiting).
Therapeutic area(s): Diseases [C] - Otorhinolaryngologic Diseases [C09]; Diseases [C] - Nutritional and Metabolic Diseases [C18]
Gender: Female, Male. Age: 18-64 years, 65+ years. Enrolment: 56.
Status: Ongoing, recruiting. Start date (EU): 2026-03-12. Decision date: 2026-03-03. Results received: No. Last updated: 2026-03-03.

Condition(s): Hypothyroidism, Incident Kidney Dysfunction, Chronic Kidney Disease
Product: LEVOTHYROXINE SODIUM, LEVOTHYROXINE, LEVOTHYROXINE

Primary endpoint: Change eGFR from baseline to 3 months postoperatively, measured in mL/min/1.73m² using standard laboratory methods.
Endpoint(s): Serum levels of TSH, T4, and T3 at 3 months postoperatively., ThyPRO-39 composite score changes from baseline to 3 and 6 months postoperatively., Change in body weight (kg) and BMI (kg/m²) from baseline to 3 months and 6 months., In control group participants who initiate THRT at 3 months due to elevated TSH (>1.5 mIU/L), follow-up changes in eGFR and HRQoL at 6 months.

Source: https://euclinicaltrials.eu/ctis-public/view/2025-524175-23-00